EU clinical trial 2023-507137-24-00: A pilot single center, open label trial to assess the impact of doxycycline postexposure prophylaxis on antimicrobial resistance
Protocol code: ITM202302
Sponsor: Institute Of Tropical Medicine (Hospital/Clinic/Other health care facility). Phase: Therapeutic exploratory (Phase II). Countries: Belgium (ended).
Therapeutic area(s): Diseases [C] - Bacterial Infections and Mycoses [C01]
Gender: Male. Age: 18-64 years, 65+ years. Enrolment: 78.
Status: Ended. Start date (EU): 2024-03-13. End date (EU): 2025-06-19. Decision date: 2024-01-23. Results received: Yes. Last updated: 2024-03-07.

Condition(s): Bacterial sexually transmittable diseases (chlamydia, gonorrhea, syphilis)
Product: Doxycycline EG 200 mg Tabletten

Primary endpoint: Shift in the distribution of minimum inhibitory concentration (MIC) of doxycycline in rectal E. coli on day 180.
Endpoint(s): Shift in the distribution of MIC of ceftriaxone in rectal E. coli on day 180., Shift in the distribution ofMIC of ciprofloxacin in rectal E. coli on day 180., Shift in the distribution of MIC of doxycycline in rectal K. pneumoniae on day 180., Shift in the distribution of MIC of ceftriaxone in rectal K. pneumoniae on day 180, Shift in the distribution of MIC of ciprofloxacin in rectal K. pneumoniae on day 180, Shift in the distribution of MIC of doxycycline in oral streptococci on day 180, Shift in the distribution of MIC of ceftriaxone in oral streptococci on day 180, Shift in the distribution of MIC of ciprofloxacin in oral streptococci on day 180, Shift in the distribution of MIC of doxycycline in oral S. aureus on day 180, Shift in the distribution of MIC of ceftriaxone in oral S. aureus on day 180, Shift in the distribution of MIC of ciprofloxacin in oral S. aureus on day 180, Shift in the distribution of MIC of doxycycline in oral commensal Neisseria spp. on day 180, Shift in the distribution of MIC of ceftriaxone in oral commensal Neisseria spp. on day 180, Shift in the distribution of MIC of ciprofloxacin in oral commensal Neisseria spp. on day 180

Source: https://euclinicaltrials.eu/ctis-public/view/2023-507137-24-00